EU clinical trial 2024-513405-31-00: A Phase 2 multicenter, randomized, placebo controlled, double-blind study to assess the safety and efficacy of CC-486 (oral azacitidine) in combination with pembrolizumab (MK-3475) versus pembrolizumab plus placebo in subjects with previously treated locally advanced or metastatic non-small cell lung cancer
Protocol code: CC-486-NSCL-001
Sponsor: Celgene Corp. (Pharmaceutical company). Phase: Therapeutic exploratory (Phase II). Countries: Italy (ended).
Therapeutic area(s): Diseases [C] - Neoplasms [C04]
Gender: Female, Male. Age: 18-64 years, 65+ years. Enrolment: 1.
Status: Ended. Start date (EU): 2015-12-10. End date (EU): 2025-07-07. End date: 2025-07-08. Decision date: 2024-08-05. Results received: Yes. Last updated: 2025-07-03.

Condition(s): Second-line treatment of locally advanced or metastatic non-small cell lung cancer (NSCLC)
Product: Azacitidine 150mg tablet, Azacitidine 200mg tablet: film- coated tablet, azacitidine, PEMBROLIZUMAB, azacitidine

Primary endpoint: PFS measured as time from randomization to progression according to RECIST 1.1 (based on Investigator assessment)
Endpoint(s): Number (%) of subj. with SD for ≥ 18 weeks, complete response (CR) or PR (DCR)., Overall survival., Number (%) of subj. who achieve an objective CR or PR (ORR)., Safety to include the incidence of treatment-emergent adverse events (TEAEs), serious TEAEs, Grade 3-4 TEAEs, TEAEs of special interest, and laboratory abnormalities and other safety parameters., Plasma PK parameters such as maximum observed concentration (Cmax), area under the concentration-time curve (AUC), time to maximum concentration (Tmax), terminal half-life (t1/2), apparent total body clearance (CL/F) and apparent volume of distribution (Vz/F) for CC-486.

Source: https://euclinicaltrials.eu/ctis-public/view/2024-513405-31-00